EU clinical trial 2024-514730-21-00: A pHase III cluster randomIsed controlled, cross-over, non-inferiority Trial of a short course, High dose AntimicRobials vs conventional dose and Duration in critically ill patients
Sponsor: Universitair Ziekenhuis Gent (Hospital/Clinic/Other health care facility). Phase: Therapeutic confirmatory (Phase III). Countries: Netherlands (ongoing, recruiting), Belgium (ongoing, recruiting).
Therapeutic area(s): Diseases [C] - Bacterial Infections and Mycoses [C01]
Gender: Female, Male. Age: 18-64 years, 65+ years. Enrolment: 1282.
Status: Ongoing, recruiting. Start date (EU): 2025-07-01. Decision date: 2025-04-18. Results received: No. Last updated: 2026-02-19.
Decision dates by country: NL: 2025-04-18, BE: 2025-04-18

Condition(s): Bacterial infections and mycoses
Product: CEFTRIAXONE, CEFUROXIME, PIPERACILLIN AND BETA-LACTAMASE INHIBITOR, MEROPENEM, CEFOTAXIME

Primary endpoint: All-cause mortality within 90 days after inclusion.
Endpoint(s): All-cause ICU mortality., All-cause hospital mortality., New colonization or infection with a multi-resistant organism (MRSA, VRE, MDR P. aeruginosa, CRE, ESBL Enterobacterales, Acinetobacter baumannii) or C. difficile diarrhea/infection up to 28 days post inclusion., Antimicrobial free days., Recurrence of infection., Toxicity., Health related quality of life (EQ-5D-5L measured at D90)., Exposure., Clinical cure, 10. ICU length of stay, 11. Hospital length of stay, 12. Organ support free days, 13. DDDs and DOTs

Source: https://euclinicaltrials.eu/ctis-public/view/2024-514730-21-00